EU clinical trial 2023-506527-28-00: A Multicenter, Open-Label Extension Study to Assess the Long-Term Safety, Tolerability, and Efficacy of Bimekizumab in the Treatment of Study Participants with Active Axial Spondyloarthritis, Ankylosing Spondylitis, and Nonradiographic Axial Spondyloarthritis
Protocol code: AS0014
Sponsor: UCB Biopharma (Pharmaceutical company). Phase: Therapeutic confirmatory (Phase III). Countries: Hungary (ended), Poland (ended), France (ended), Belgium (ended), Czechia (ended), Spain (ended), Germany (ended).
Therapeutic area(s): Diseases [C] - Immune System Diseases [C20]
Gender: Female, Male. Age: 18-64 years, 65+ years. Enrolment: 568.
Status: Ended. Start date (EU): 2020-06-29. End date (EU): 2025-10-02. Decision date: 2024-07-02. Results received: No. Last updated: 2025-03-24.
Decision dates by country: BE: 2024-07-03, FR: 2024-07-02, DE: 2024-07-08, HU: 2024-07-02, ES: 2024-07-03, PL: 2024-07-15, CZ: 2024-07-04

Condition(s): Axial Spondyloarthritis
Product: bimekizumab

Primary endpoint: 1. Incidence of treatment-emergent adverse events (TEAEs) during the study 2. Incidence of serious adverse events (SAEs) during the study 3. Treatment-emergent adverse events (TEAEs) leading to withdrawal from the study
Endpoint(s): 1. Assessment of SpondyloArthritis International Society 40% response criteria (ASAS40) response at Week 28, 2. Assessment of SpondyloArthritis International Society 40% response criteria (ASAS40) response at Week 52, 3. Assessment of SpondyloArthritis International Society 40% response criteria (ASAS40) response at Week 112, 4. Assessment of SpondyloArthritis International Society 20% response criteria (ASAS20) response at Week 28, 5. Assessment of SpondyloArthritis International Society 20% response criteria (ASAS20) response at Week 52, 6. Assessment of SpondyloArthritis International Society 20% response criteria (ASAS20) response at Week 112, 7. Change from Baseline in Bath Ankylosing Spondylitis Disease Activity Index (BASDAI) at Week 28, 8. Change from Baseline in Bath Ankylosing Spondylitis Disease Activity Index (BASDAI) at Week 52, 9. Change from Baseline in Bath Ankylosing Spondylitis Disease Activity Index (BASDAI) at Week 112, 10. Assessment of SpondyloArthritis International Society partial remission (ASAS-PR) at Week 28, 11. Assessment of SpondyloArthritis International Society partial remission (ASAS-PR) at Week 52, 12. Assessment of SpondyloArthritis International Society partial remission (ASAS-PR) at Week 112, 13. Assessment of Ankylosing Spondylitis Disease Activity Score-C-reactive protein (ASDAS-CRP) at Week 28, 14. Assessment of Ankylosing Spondylitis Disease Activity Score-C-reactive protein (ASDAS-CRP) at Week 52, 15. Assessment of Ankylosing Spondylitis Disease Activity Score-C-reactive protein (ASDAS-CRP) at Week 112, 16. Assessment of SpondyloArthritis International Society (ASAS) 5/6 response at Week 28, 17. Assessment of SpondyloArthritis International Society (ASAS) 5/6 response at Week 52, 18. Assessment of SpondyloArthritis International Society (ASAS) 5/6 response at Week 112, 19. Change from Baseline in Bath Ankylosing Spondylitis Functional Index (BASFI) at Week 28, 20. Change from Baseline in Bath Ankylosing Spondylitis Functional Index (BASFI) at Week 52, 21. Change from Baseline in Bath Ankylosing Spondylitis Functional Index (BASFI) at Week 112, 22. Change from Baseline in Nocturnal Spinal Pain Numeric Rating Scale (NRS) at Week 28, 23. Change from Baseline in Nocturnal Spinal Pain Numeric Rating Scale (NRS) at Week 52, 24. Change from Baseline in Nocturnal Spinal Pain Numeric Rating Scale (NRS) at Week 112, 25. Change from Baseline in Ankylosing Spondylitis Quality of Life (ASQoL) at Week 28, 26. Change from Baseline in Ankylosing Spondylitis Quality of Life (ASQoL) at Week 52, 27. Change from Baseline in Ankylosing Spondylitis Quality of Life (ASQoL) at Week 112, 28. Change from Baseline in the Short Form 36-Item Health Survey (SF-36) physical component summary (PCS) at Week 28, 29. Change from Baseline in the Short Form 36-Item Health Survey (SF-36) physical component summary (PCS) at Week 52, 30. Change from Baseline in the Short Form 36-Item Health Survey (SF-36) physical component summary (PCS) at Week 112, 31. Change from Baseline in Bath Ankylosing Spondylitis Disease Metrology Index (BASMI) at Week 28, 32. Change from Baseline in Bath Ankylosing Spondylitis Disease Metrology Index (BASMI) at Week 52, 33. Change from Baseline in Bath Ankylosing Spondylitis Disease Metrology Index (BASMI) at Week 112, 34. Change from Baseline in the Maastricht Ankylosing Spondylitis Enthesitis (MASES) Index at Week 28, 35. Change from Baseline in the Maastricht Ankylosing Spondylitis Enthesitis (MASES) Index at Week 52, 36. Change from Baseline in the Maastricht Ankylosing Spondylitis Enthesitis (MASES) Index at Week 112

Source: https://euclinicaltrials.eu/ctis-public/view/2023-506527-28-00